EU clinical trial 2025-523165-19-00: A Phase 1a/1b, Open-Label Study Evaluating the Safety, Tolerability, Pharmacokinetics, Pharmacodynamics, and Preliminary Antitumor Activity of BG-75098 Alone and in Combination With Other Agents in Patients With Advanced Solid Tumors
Sponsor: BeOne Medicines I GmbH (Pharmaceutical company). Phase: Human Pharmacology (Phase I)- First administration to humans. Countries: Denmark (ongoing, recruiting).
Therapeutic area(s): Diseases [C] - Neoplasms [C04]
Gender: Female, Male. Age: 18-64 years, 65+ years. Enrolment: 15.
Status: Ongoing, recruiting. Start date (EU): 2026-02-10. Decision date: 2025-12-11. Results received: No. Last updated: 2026-07-08.

Condition(s): Advanced, metastatic or unresectable solid tumors

Source: https://euclinicaltrials.eu/ctis-public/view/2025-523165-19-00